EU clinical trial 2022-502621-17-00: Treatment with zoledronate subsequent to denosumab in osteoporosis 2
Protocol code: 01.12.2022
Sponsor: Aarhus University Hospital (Hospital/Clinic/Other health care facility). Phase: Phase III and phase IV (Integrated). Countries: Denmark (ongoing, recruiting).
Therapeutic area(s): Diseases [C] - Musculoskeletal Diseases [C05]
Gender: Female. Age: 18-64 years, 65+ years. Enrolment: 1.
Status: Ongoing, recruiting. Start date (EU): 2023-05-11. Decision date: 2023-02-02. Results received: No. Last updated: 2026-07-01.

Condition(s): Osteoporosis
Product: Zoledronate EG 5mg/100ml Infusionslösung, 100 mL isotonic saline

Primary endpoint: Change in lumbar spine BMD after 12 and 36 months., The proportion of patients who fails to maintain BMD (total hip, femoral neck and spine) after 12 months. Failure is defined as ≥ 3 % BMD loss at the lumbar spine or ≥ 5 % BMD loss at the femoral neck or total hip.
Endpoint(s): Changes in total hip and femoral neck BMD after 12 and 36 months., Changes in trabecular bone volume fraction (bone volume/tissue volume, BV/TV) and cortical porosity measured by high-resolution peripheral quantitative computed tomography (HR-pQCT) at the radius and tibia after 12 and 36 months., Changes in CTX and procollagen type I N-terminal propeptide (PINP) after 3, 6, 12, 24 and 36 months., Morphometric vertebral fractures assessed by vertebral fracture assessment (VFA) after 12 and 36 months or by spinal x-ray if clinical suspicion of vertebral fracture., Serum RANKL/OPG, tartrate-resistant acid phosphatase type 5b (TRAcP-5b), sclerostin and Dickkopf-1 (Dkk-1) at 0, 1, 3, 6 and 12 months, Molecular bone histology of accumulating osteoclast activation sites and pre-osteoclasts as well as single-nucleus transcriptomics on jamshidi biopsies at baseline in a total of 100 patients from groups 1 and 2 and in up to 15 participants in groups 1 and 2 at month 3 with a strong rebound response (p-CTX > 0.6 ug/l)., Osteoclasts differentiation, fusion, function, and response to ZOL in cultures derived from peripheral blood at baseline from groups 1 and 2. 30 patients will be recruited from each group, hence 60 patients., Epigenetic marker analysis with special focus on genes involved in osteoclast activation, differentiation, fusion, function and response to ZOL. Samples collected at baseline from all participants., Muscle mass assessed by whole-body DXA and muscle strength assessed by handgrip strength and muscle strength over the knee and elbow joints. A total of 100 patients from groups 1 and 2 will be investigated at base-line month 3 and 12., Insulin sensitivity assessed by Hb1Ac, HOMA-IR and OGTT. Accumulation of advanced glycation end products (AGEs) will also be evaluated.

Source: https://euclinicaltrials.eu/ctis-public/view/2022-502621-17-00